EU clinical trial 2024-516411-24-00: A MULTICENTER, DOUBLE-BLIND, RANDOMIZED STUDY TO EVALUATE THE EFFECTS OF TASIMELTEON VS. PLACEBO IN TREATING PEDIATRIC INSOMNIA
Protocol code: VP-VEC-162-3108
Sponsor: Vanda Pharmaceuticals Netherlands B.V., Vanda Pharmaceuticals Inc. (Pharmaceutical company). Phase: Therapeutic confirmatory (Phase III). Countries: Poland (ongoing, recruiting), Germany (ongoing, recruiting).
Therapeutic area(s): Diseases [C] - Nervous System Diseases [C10]
Gender: Female, Male. Age: 0-17 years. Enrolment: 90.
Status: Ongoing, recruiting. Start date (EU): 2026-02-25. Decision date: 2025-09-23. Results received: No. Last updated: 2026-07-03.
Decision dates by country: PL: 2025-09-27, DE: 2025-09-23

Condition(s): Insomnia Disorder
Product: Placebo liquid formulation will be indistinguishable from its tasimelteon counterpart and will be administered in the same way., Tasimelteon

Primary endpoint: Sleep as measured by daily sleep diary
Endpoint(s): Nighttime subjective sleep parameters as measured by daily sleep diary, Patient Global Impression of Change scale (PGI-C), Clinical Global Impression of Change scale (CGI-C), Caregiver Global Impression of Change scale (CaGI-C), Epworth Sleepiness Scale for Children and Adolescents (ESS-CHAD), Sheehan Disability Scale for Pediatrics and Adolescents (SDS-P/A), Aberrant Behavior Checklist (ABC), Actigraphy parameters, Tasimelteon pharmacokinetics (PK) in 2-year-old participants

Source: https://euclinicaltrials.eu/ctis-public/view/2024-516411-24-00